EU clinical trial 2023-508300-37-00: Triple therapy effectiveness in COPD patients with characteristics of asthma: A pragmatic primary care trial - The TRACkER trial
Protocol code: GPRI-19102-TRA
Sponsor: General Practitioners Research Institute B.V. (Pharmaceutical company). Phase: Therapeutic use (Phase IV). Countries: Netherlands (ended).
Therapeutic area(s): Diseases [C] - Respiratory Tract Diseases [C08]
Gender: Female, Male. Age: 18-64 years, 65+ years. Enrolment: 316.
Status: Ended. End date (EU): 2024-02-19. Decision date: 2023-10-24. Results received: No. Last updated: 2023-10-24.

Condition(s): Chronic Obstructive Pulmonary Disease (COPD)
Product: FORMOTEROL AND ACLIDINIUM BROMIDE, FORMOTEROL AND GLYCOPYRRONIUM BROMIDE, FORMOTEROL, GLYCOPYRRONIUM BROMIDE AND BECLOMETASONE, OLODATEROL AND TIOTROPIUM BROMIDE, VILANTEROL AND UMECLIDINIUM BROMIDE, INDACATEROL AND GLYCOPYRRONIUM BROMIDE

Primary endpoint: The primary outcome of this study is the difference in the proportion of patients with a clinically relevant improvement in health status (≥0.4 improvement on the CCQ) between the triple therapy group and LABA/LAMA treatment groups at the end of the 26 weeks intervention period.

Source: https://euclinicaltrials.eu/ctis-public/view/2023-508300-37-00